EU clinical trial 2024-520057-20-00: A Phase 4 (Phase 2 in European Union), Open-Label, Multicenter Study Evaluating the Absorption and Systemic Pharmacokinetics and HPA Axis Suppression Potential of Topically Applied IDP-118 Lotion in Pediatric Subjects with Moderate to Severe Plaque Psoriasis
Protocol code: V01-118A-401
Sponsor: Bausch Health Americas Inc. (Pharmaceutical company). Phase: Therapeutic exploratory (Phase II). Countries: Poland (ended).
Therapeutic area(s): Diseases [C] - Skin and Connective Tissue Diseases [C17]
Gender: Female, Male. Age: 0-17 years, 18-64 years, 65+ years. Enrolment: 26.
Status: Ended. Start date (EU): 2021-03-09. End date (EU): 2025-11-05. End date: 2025-11-06. Decision date: 2025-01-28. Results received: Yes. Last updated: 2025-01-28.

Condition(s): Plaque Psoriasis
Product: Duobrii

Primary endpoint: 1.) 1 Safety of IDP-118 (HP 0.01% and Taz 0.045%) Lotion administered topically once daily 2.) Systemic exposure of HP, Taz and its metabolite, tazarotenic acid after topical application of IDP-118 Lotion once daily 3.) Hypothalamic-pituitary-adrenal (HPA) axis suppression potential for IDP-118 Lotion when applied once daily

Source: https://euclinicaltrials.eu/ctis-public/view/2024-520057-20-00